EU clinical trial 2025-520681-22-00: Using a fixed dosage of follitropin delta for ovarian stimulation for intrauterine insemination. Rekovelle for Intrauterine Successful Experience (RISE )
Protocol code: RISE
Sponsor: Centre Hospitalier Intercommunal Creteil (Hospital/Clinic/Other health care facility). Phase: Therapeutic exploratory (Phase II). Countries: France (ongoing, recruiting).
Therapeutic area(s): Diseases [C] - Female Urogenital Diseases and Pregnancy Complications [C13]
Gender: Female. Age: 18-64 years. Enrolment: 80.
Status: Ongoing, recruiting. Start date (EU): 2025-12-17. Decision date: 2025-07-31. Results received: No. Last updated: 2026-03-31.

Condition(s): Infertility
Product: REKOVELLE 36 micrograms/1.08 mL solution for injection in a pre-filled pen, Ovitrelle 250 micrograms solution for injection in pre-filled pen, REKOVELLE 12 micrograms/0.36 mL solution for injection in a pre-filled pen, DUPHASTON 10 mg, comprimé pelliculé, UTROGESTAN 200 mg, capsule molle orale ou vaginale

Primary endpoint: Percentage of cycles with two mature follicles (total of two ovaries) at the stage of triggering ovulation (follicles diameter ≥14 mm) and no follicles between 10 et 13 mm.
Endpoint(s): Number of follicles ≥14 mm on the day of trigger ( by cycle), Number of follicles between 10 et 13 mm on the day of trigger (by cycle), Percentage of cycles with two mature follicles (total of two ovaries) at the stage of triggering ovulation (follicles diameter ≥14 mm) and no follicles between 10 et 13 mm for each cycle and according to dose adjustment, Presence or absence of dose adjustment in subsequent cycles, Dose adjustment on subsequent cycle(s) : number and percentage of cycles and quantity of mcg, E2, PG, LH levels on the day of trigger, Frequency of spontaneous LH surge by cycle , at the end of stimulation (last day of stimulation), Cycle cancellation rate (by cycle) . The Cycle is cancelled when more than 2 follicles ≥ 14mm or 4 follicles ≥ 10mm, or if there is no response to treatment, Pregnancy loss rate, Rate of Biochemical pregnancy (βhCG test), Clinical pregnancy, Ongoing pregnancy (by initiated cycle, by insemination and cumulative rates) by patient, Pregnancy rate with one follicle or two follicles diameter ≥14 mm, Multiple pregnancy rate, Time to pregnancy (time between 1st stimulation and date of pregnancy), The number of stimulation days, Unexpected and related Events, Duration in days between each cycle, The duration of stimulation for each cycle, Endometrial thickness, Pregnancy outcome according to the cycle rank, Cumulative pregnancy outcome up to 3 cycles, Number of OHSS, Number of ectopic pregnancy, Number of ovarian torsion, Number of thromboembolic events, Causes of cycle cancellation

Source: https://euclinicaltrials.eu/ctis-public/view/2025-520681-22-00